EU clinical trial 2025-521838-29-00: Study of IADADEMSTAT for the Treatment of Sickle Cell Disease.
Protocol code: CL05-ORY-1001
Sponsor: Oryzon Genomics S.A. (Pharmaceutical company). Phase: Human Pharmacology (Phase I)- Other. Countries: Spain (ongoing, recruiting).
Therapeutic area(s): Diseases [C] - Hemic and Lymphatic Diseases [C15]
Gender: Female, Male. Age: 18-64 years, 65+ years. Enrolment: 39.
Status: Ongoing, recruiting. Start date (EU): 2025-10-16. Decision date: 2025-08-20. Results received: No. Last updated: 2026-07-17.

Condition(s): Sickle Cell Disease

Source: https://euclinicaltrials.eu/ctis-public/view/2025-521838-29-00